EU clinical trial 2022-500041-24-00: SPRING Rollover
Protocol code: WIN002
Sponsor: Worldwide Innovative Network (Non-Pharmaceutical company). Phase: Phase I and Phase II (Integrated)- Other. Countries: Spain (ongoing, recruiting).
Therapeutic area(s): Diseases [C] - Neoplasms [C04]
Gender: Female, Male. Age: 65+ years. Enrolment: 1.
Status: Ongoing, recruiting. Start date (EU): 2022-09-27. Decision date: 2022-06-01. Results received: No. Last updated: 2022-06-01.

Condition(s): Lung cancer (non-small cell lung cancer)

Source: https://euclinicaltrials.eu/ctis-public/view/2022-500041-24-00